EU clinical trial 2024-514591-40-00: Safety and efficacy of hCD1a-CAR T (OC-1) therapy, in patients with relapsed/refractory (R/R) T-cell acute lymphoblastic leukemia/lymphoma (T-ALL/LL)_CARxALL
Protocol code: OC-01-21001- CARxALL
Sponsor: Onechain Immunotherapeutics S.L. (Pharmaceutical company). Phase: Human Pharmacology (Phase I)- First administration to humans. Countries: Spain (ongoing, recruiting).
Therapeutic area(s): Diseases [C] - Hemic and Lymphatic Diseases [C15]
Gender: Female, Male. Age: 0-17 years, 18-64 years, 65+ years. Enrolment: 20.
Status: Ongoing, recruiting. Start date (EU): 2023-01-31. Decision date: 2024-07-17. Results received: No. Last updated: 2026-04-15.

Condition(s): T-cell Acute Lymphoblastic Leukemia, T-cell acute lymphoblastic Lymphoma
Product: hCD1a-CAR T

Primary endpoint: Number of adverse events grade III-IV using Common Toxicity Criteria for Adverse Events (CTCAE) version 5., Incidence of severe Cytokine release syndrome (CRS) # grade III and Immune effector cell-associated neurotoxicity syndrome (ICANS) # grade II, Proportion of patients with non-relapse, treatment-related mortality (NRM), Number of adverse events of special interest (AESI), Assessment of the immunological homeostasis, through the description of lymphocytes subpopulations at each study timepoint., Incidence of severe (#3) treatment-related dermatological events., Number of patients developing dose limiting toxicity (DLT)
Endpoint(s): Remission rate: Percentage of patients presenting complete response (CR) or incomplete count recovery (CRi) at any point after treatment, Duration of remission: The duration of the remission will be assessed from the first documented date of remission status until progression (in days), Minimal residual disease (MRD) response by flow cytometry: blast count among patients presenting bone marrow complete response (sensitivity 10-4)., Progression-free survival: time since the first infusion to the documented loss of response. In patients not presenting a CR or CRi progression free survival will be zero, Overall survival time since first infusion to date of death, Persistence of OC-1, as determined by flow cytometry and quantitative analysis by qPCR

Source: https://euclinicaltrials.eu/ctis-public/view/2024-514591-40-00